EU clinical trial 2024-513305-32-00: A Phase 2, multicentre open-label study to explore the effects of sonelokimab in patients with moderate-to-severe pustulosis palmoplantaris
Protocol code: M1095-PPP-201
Sponsor: MoonLake Immunotherapeutics AG (Pharmaceutical company). Phase: Therapeutic exploratory (Phase II). Countries: Germany (ended).
Therapeutic area(s): Diseases [C] - Skin and Connective Tissue Diseases [C17]
Gender: Female, Male. Age: 18-64 years, 65+ years. Enrolment: 30.
Status: Ended. Start date (EU): 2024-10-29. End date (EU): 2025-09-30. Decision date: 2024-09-20. Results received: No. Last updated: 2025-07-29.

Condition(s): Palmoplantar Pustulosis
Product: Sonelokimab

Primary endpoint: Percent change from baseline in PPPASI score at Week 16

Source: https://euclinicaltrials.eu/ctis-public/view/2024-513305-32-00